EU clinical trial 2022-502790-42-00: Pilot-trial of methotrexate, tafasitamab (Minjuvi®), lenalidomide (Revlimid®) and rituximab in patients ineligible for HCT-ASCT with primary central nervous system lymphoma (PCNSL) -MTR²
Protocol code: Uni-Koeln-4968
Sponsor: University Of Cologne (Educational Institution). Phase: Therapeutic exploratory (Phase II). Countries: Germany (ongoing, recruitment ended).
Therapeutic area(s): Diseases [C] - Nervous System Diseases [C10]
Gender: Female, Male. Age: 18-64 years, 65+ years. Enrolment: 20.
Status: Ongoing, recruitment ended. Start date (EU): 2024-06-24. Decision date: 2023-11-09. Results received: No. Last updated: 2025-12-22.

Condition(s): Primary Central Nervous Lymphoma (PCNSL)
Product: TAFASITAMAB, RITUXIMAB, LENALIDOMIDE, METHOTREXATE, LENALIDOMIDE

Primary endpoint: Efficacy will be determined using the complete response rate (CRR) after at least 2 cycles of treatment with MTR² (Methotrexate, Tafasitamab, Rituximab, Revlimid), as determined by independent review committee (IRC) and according to International Primary CNS Lymphoma Collaborative Group (IPCG) criteria
Endpoint(s): Best overall response rate (BORR) after 4 cycles of MTR² is defined as the rate of patients having achieved a CR or PR according to at least one post-baseline tumor assessment, Objective response rate (ORR) at RA I and RA II defined as rate of patients showing CR, CRr or PR, Progression-free survival (PFS) will be calculated for each patient as time between the start of treatment with MTR2 and the date of first progression, relapse or death or, in cases of continuing response, the date of the last documented follow-up . One-year PFS rates and 90% confidence intervals will be estimated using the Kaplan-Meier method., Overall survival (OS) will be calculated for each patient as time between the start of treatment with MTR² and the date of death or the date of the last documented followup (FU-eCRF, QoL CRF or written medical report). One-year OS rates and 90% confidence intervals will be estimated using the Kaplan-Meier method., Incidence and severity of adverse events, including toxic deaths during induction therapy will be summarized based on CTCAE grades, Quality of life and neurocognitive impairment over time as determined by EORTC QLQC30 and BN20 questionnaires as well as Montreal Cognitive Assessment (MoCA), respectively, Safety as determined by incidence and severity of adverse events, Feasibility as determined by proportion of patients completing 4 cycles of MTR2 and relative dose intensity of planned and administered cycles

Source: https://euclinicaltrials.eu/ctis-public/view/2022-502790-42-00